EU clinical trial 2024-520108-25-00: A Phase 2, Open-label, Randomized Trial to Evaluate Two Dosing Regimens of Subcutaneous Formulation of Nivolumab in Combination with Intravenous Ipilimumab and Chemotherapy in Participants with Previously Untreated Metastatic or Recurrent NSCLC (CheckMate-1533)
Protocol code: CA209-1533
Sponsor: Bristol-Myers Squibb Services Unlimited Company (Pharmaceutical company). Phase: Therapeutic exploratory (Phase II). Countries: Italy (ongoing, recruiting), Greece (ongoing, recruiting), Romania (ongoing, recruitment ended), France (ongoing, recruitment ended), Poland (ongoing, recruitment ended).
Therapeutic area(s): Diseases [C] - Neoplasms [C04]
Gender: Female, Male. Age: 18-64 years, 65+ years. Enrolment: 40.
Start date (EU): 2025-11-05. Decision date: 2025-08-20. Results received: No. Last updated: 2026-07-06.
Decision dates by country: RO: 2025-08-25, IT: 2025-08-20, PL: 2025-08-22, FR: 2025-08-22, GR: 2025-08-20

Condition(s): Non-small cell lung cancer (NSCLC)
Product: CISPLATIN, PEMETREXED, Nivolumab Subcutaneous, CARBOPLATIN, PACLITAXEL, Ipilimumab

Primary endpoint: Measuring various PK parameters of nivolumab SC in the blood during the first treatment cycle., Measuring the amount of nivolumab SC left in the body just before the next dose is given on the first day of the seventh treatment cycle.
Endpoint(s): Recording the incidence of side effects (adverse events or AEs), serious adverse events (SAEs), drug-related AEs, immune-mediated AEs (IMAEs), specific AEs, AEs leading to discontinuation, and deaths until 100 days post end of treatment., Measuring the incidence of antibodies against nivolumab SC and ipilimumab IV, including neutralizing antibodies if applicable, until 100 days post end of treatment., Evaluating the PK parameters of ipilimumab IV in the blood when given with nivolumab SC and chemotherapy during the first treatment cycle.

Source: https://euclinicaltrials.eu/ctis-public/view/2024-520108-25-00